EU clinical trial 2023-510448-20-00: A study to test how well healthy people tolerate spesolimab when given in 2 different ways.
Protocol code: 1368-0151
Sponsor: Boehringer Ingelheim International GmbH (Pharmaceutical company). Phase: Human Pharmacology (Phase I)- Other. Countries: Belgium (ended).
Therapeutic area(s): Not possible to specify
Gender: Female, Male. Age: 18-64 years. Enrolment: 60.
Status: Ended. Start date (EU): 2024-07-30. End date (EU): 2025-02-04. Decision date: 2024-07-17. Results received: No. Last updated: 2024-07-17.

Condition(s): Healthy volunteer trial

Source: https://euclinicaltrials.eu/ctis-public/view/2023-510448-20-00